EU clinical trial 2023-503717-30-00: The effect of Desflurane versus Sevoflurane versus Propofol on postoperative Delirium in elderly patients undergoing moderate- to high-risk major abdominal surgery – a prospective, double-blinded, randomized, clinical trial RAPID II Trial
Protocol code: RAPIDII_01
Sponsor: Medical University Of Vienna (Educational Institution). Phase: Phase III and phase IV (Integrated). Countries: Austria (ongoing, recruiting).
Therapeutic area(s): Diseases [C] - Pathological Conditions, Signs and Symptoms [C23]
Gender: Female, Male. Age: 65+ years. Enrolment: 1332.
Status: Ongoing, recruiting. Start date (EU): 2023-07-19. Decision date: 2023-06-19. Results received: No. Last updated: 2024-10-26.

Condition(s): Elderly patients undergoing moderate- to high-risk major non cardiac surgery
Product: Propofol „Fresenius" 2 % mit MCT - Emulsion zur Injektion oder Infusion, Sevorane – Inhalationsnarkotikum, SUPRANE - Inhalationsnarkotikum

Primary endpoint: Incidence of postoperative delirium within the first five postoperative days between maintenance of anesthesia with desflurane, sevoflurane or propofol in elderly patients undergoing noncardiac surgery
Endpoint(s): Incidence of postoperative cognitive dysfunction, Incidence of long-term postoperative cognitive dysfunction, Incidence of postoperative nausea and vomiting (PONV) within the first two postoperative hours, Incidence of PONV from two hours after surgery until the fifth postoperative day, Administration of supplemental oxygen in PACU or ICU for SpO2 ≥ 93%., Intraoperative duration of mean arterial pressure <65mmHg and overall amount of intraoperatively administered catecholamines (including phenylephrine, norepinephrine, epinephrine, etilefrine, ephedrine), Length of stay in the ICU after surgery until hospital discharge, Number of days at home within the first 30 postoperative days

Source: https://euclinicaltrials.eu/ctis-public/view/2023-503717-30-00